EU clinical trial 2024-511420-13-00: Local Antibiotic Delivery for Community Acquired Pneumonia (LANDCAP 2)
Sponsor: Gentofte Hospital (Hospital/Clinic/Other health care facility). Phase: Therapeutic exploratory (Phase II). Countries: Denmark (authorised, recruitment pending).
Therapeutic area(s): Diseases [C] - Bacterial Infections and Mycoses [C01]; Diseases [C] - Respiratory Tract Diseases [C08]
Gender: Female, Male. Age: 18-64 years, 65+ years. Enrolment: 460.
Status: Authorised, recruitment pending. Decision date: 2024-07-11. Results received: No. Last updated: 2026-07-09.

Condition(s): Community-acquired pneumonia
Product: Piperacillin/Tazobactam "Stada", pulver til infusionsvæske, opløsning, Quinsair 240 mg nebuliser solution, SODIUM CHLORIDE, SALINE

Primary endpoint: Days alive and out of hospital at 14 days.
Endpoint(s): Days alive and out of hospital at 30 days., Days alive and out of hospital and without antibiotics at 30 days., Proportion of patient with antibiotic-related side-effects, Differences in gut microbiome diversity and composition in stool and oral samples on day 5 and on day 60., All-cause mortality at 30 days., Proportion of patients converted to guideline-based therapy according to algorithm as described in the section titled “Procedures, patient monitoring and data collection”., Proportion of patients readmitted, admitted to ICU or dead at 30 days., CRP on day 5, continuous and binary (higher than on any day from 1 to 4 including baseline)., MAP ≤ 65 OR respiratory frequency > 25 OR pulse > 100 OR needing supplemental oxygen (1-4 of these fulfilled) on day 5., PCT on day 5, continuous and binary (higher than on any day from 1 to 4 including baseline), Temperature ≥ 38.0 on day 5., Patient reported outcome measurements: Changes in Visual Analogue Scales for dyspnoea, cough, and fatigue from day 1 to day 5.

Source: https://euclinicaltrials.eu/ctis-public/view/2024-511420-13-00